EU clinical trial 2024-516111-25-00: MIRASOL: A Randomized, Open-label, Phase 3 Study of Mirvetuximab Soravtansine vs. Investigator’s Choice of Chemotherapy in Platinum- Resistant Advanced High-Grade Epithelial Ovarian, Primary Peritoneal, or Fallopian Tube Cancers with High Folate Receptor-Alpha Expression
Protocol code: IMGN853-0416
Sponsor: Immunogen Inc. (Pharmaceutical company). Phase: Therapeutic confirmatory (Phase III). Countries: France (ended).
Therapeutic area(s): Diseases [C] - Neoplasms [C04]
Gender: Female. Age: 18-64 years, 65+ years. Enrolment: 1.
Status: Ended. Start date (EU): 2020-11-09. End date (EU): 2024-10-29. End date: 2024-10-30. Decision date: 2024-10-15. Results received: Yes. Last updated: 2024-10-15.

Condition(s): Platinum-Resistant Advanced High-Grade Epithelial Ovarian, Primary Peritoneal, or Fallopian Tube Cancers with High Folate Receptor-Alpha Expression
Product: Pred Forte 1% w/v, Eye Drops Suspension, Topotecan AHCL 1 mg/ml concentrato per soluzione per infusione, Topotecan Accord 1 mg/ ml Konzentrat zur Herstellung einer Infusionslösung, Topotecan Accord 1 mg/ ml Konzentrat zur Herstellung einer Infusionslösung, Paclitaxel 6 mg/mL concentrate for solution for infusion, Topotecan Accord 1 mg/ml koncentratas infuziniam tirpalui, Topotecan Hospira 4 mg/4 ml concentrate for solution for infusion, Caelyx pegylated liposomal 2 mg/ml concentrate for solution for infusion, Caelyx pegylated liposomal 2 mg/ml concentrate for solution for infusion, Mirvetuximab Soravtansine, Topotecan Hospira 4 mg/4 ml concentrate for solution for infusion

Primary endpoint: PFS, defined as the time from date of randomization until Investigator-assessed progressive disease (PD) or death, whichever occurs first. Results will be summarized by arm − Kaplan-Meier method for survival function estimate − Stratified Cox proportional hazard regression for hazard ratio (HR) estimate − Stratified log-rank test for hypothesis testing
Endpoint(s): Objective response includes best response of complete response (CR) or partial response (PR) as assessed by the Investigator − Stratified Cochran-Mantel-Haenszel (CMH) test for treatment comparison − Clopper-Pearson method for 95% CI estimation, OS defined as the time from date of randomization until the date of death. Patients alive at the time of analysis will be censored at the last known date known to be alive − Kaplan-Meier method for survival function estimate − Stratified Cox proportional hazard regression for HR estimate − Stratified log-rank test for hypothesis testing, Primary PRO assessment, defined as the number of patients achieving at least 15 point absolute improvement at Week 8 or Week 9 in the abdominal/GI scale of EORTC QLQ-OV28, DOR defined as the time from initial response until Investigator-assessed PD for all patients who achieve a confirmed objective response (PR or CR) − Kaplan-Meier method for survival function estimate − Unstratified Cox proportional hazard regression for HR estimate − Unstratified log-rank test for hypothesis testing, CA-125 response determined using the GCIG criteria defined in the protocol. CA-125 response per GCIG criteria will be determined programmatically, PFS2 defined as the time from date of randomization until second disease progression or death whichever occurs first. Results will be summarized by arm, TEAEs, laboratory test results, physical examination findings, and vital signs

Source: https://euclinicaltrials.eu/ctis-public/view/2024-516111-25-00